EU clinical trial 2023-510342-24-00: A long-term safety and efficacy study of N-Acetyl-GED-0507-34-LEVO gel 5%, in subjects with acne vulgaris (GEDACNE-LT)
Protocol code: NACGED0507ACN0123LT
Sponsor: PPM Services S.A. (Pharmaceutical company). Phase: Therapeutic confirmatory (Phase III). Countries: Italy (ongoing, recruitment ended), Spain (ended), Poland (ongoing, recruitment ended).
Therapeutic area(s): Diseases [C] - Skin and Connective Tissue Diseases [C17]
Gender: Female, Male. Age: 0-17 years, 18-64 years. Enrolment: 799.
Start date (EU): 2024-11-11. Decision date: 2024-10-03. Results received: No. Last updated: 2026-08-07.
Decision dates by country: ES: 2024-10-03, PL: 2024-10-07, IT: 2024-10-03

Condition(s): Acne vulgaris
Product: N-Acetyl-GED-0507-34-Levo GEL 5%

Primary endpoint: Safety endpoint: Incidence of all Adverse Events (AEs), Treatment-Emergent Adverse Events (TEAES), Adverse Drug Reactions (ADRs), Serious Adverse Events (SAEs) throughout the study; with special attention to local TEAEs concerning the treated facial area (local dermal safety), and systemic TEAEs, Safety endpoint: Frequency of discontinuation of treatment due to TEAEs, Safety endpoint: Changes from baseline of vital signs during the study, Safety endpoint: Physical examination during the study, Safety endpoint: Changes from baseline of laboratory test over the study duration., Safety endpoint: Change from baseline of local tolerability- Application site signs/symptoms during the study* *Local tolerability will be evaluated based on the following signs and symptoms: application site non-lesional erythema, application site exfoliation, and application site dryness, stinging, burning, itching. For each sign/symptom, a severity score will be assigned using a 4-point scale from 0 = absent to 3 = severe., Safety endpoint: Assessment of overall application site irritation over the study duration.
Endpoint(s): Efficacy endpoint - FACE: Percentage of patients who have improvement of IGA score at each time point (1,2 points), vs baseline score, Efficacy endpoint - FACE: The percentage change from baseline in total lesion count (inflammatory plus non-inflammatory) at each time point, Efficacy endpoint - FACE: Absolute change from baseline in total lesion count at each time point, Efficacy endpoint - FACE: Change from baseline in inflammatory lesion count (percentage and absolute), at each time point, Efficacy endpoint - FACE: Change from baseline in non-inflammatory lesion count (percentage and absolute), at each time point, Efficacy endpoint - TRUNK: Percentage of patients who have improvement of PGA score at each time point (1,2 points), vs baseline score, Efficacy endpoint - TRUNK: The percentage change from baseline in total lesion count (inflammatory plus non-inflammatory) at each time point, Efficacy endpoint - TRUNK: Absolute change from baseline in total lesion count at each time point, Efficacy endpoint - TRUNK: Change from baseline in inflammatory lesion count (percentage and absolute), at each time point, Efficacy endpoint - TRUNK: Change from baseline in non-inflammatory lesion count (percentage and absolute), at each time point., Efficacy endpoint - OTHER: Dermatology Life Quality Index (DLQI) / Children’s Dermatology Life Quality Index (C-DLQI for patients from 9 to 16 years old), completed by the patient at Baseline, Wk12, and Wk52 visits (prior to any Investigator assessments to not impact the patient’s answers to the quality-of-life questionnaires), Efficacy endpoint - OTHER: Additional Assessment by Scale for Acne Severity of additional evaluation at Baseline, Wk12, Wk26, Wk38 and Wk52 visits., Efficacy endpoint - OTHER: At Baseline, Wk12 and Wk52 additional documentation will be optional. The area defined for additional assessments is only the face.

Source: https://euclinicaltrials.eu/ctis-public/view/2023-510342-24-00